EU clinical trial 2024-511102-22-00: Phase II study of standard of care therapy azacitidine (AZA) combined with venetoclax (VEN) and Tagraxofusp (TAG) in patients with higher-Risk chronic myelomonocytic Leukemia (CMML): the PATROL Study
Protocol code: PATROL
Sponsor: GCP-Service International West GmbH (Pharmaceutical company). Phase: Therapeutic exploratory (Phase II). Countries: Germany (ongoing, recruiting), Italy (ongoing, recruiting), Spain (ongoing, recruiting).
Therapeutic area(s): Diseases [C] - Hemic and Lymphatic Diseases [C15]
Gender: Female, Male. Age: 18-64 years, 65+ years. Enrolment: 30.
Status: Ongoing, recruiting. Start date (EU): 2025-05-13. Decision date: 2025-03-07. Results received: No. Last updated: 2026-05-18.
Decision dates by country: IT: 2025-03-17, ES: 2025-03-07, DE: 2025-03-07

Condition(s): chronic myelomonocytic Leukemia
Product: Venetoclax, ELZONRIS 1 mg/mL concentrate for solution for infusion, Venetoclax, Venetoclax

Primary endpoint: The primary outcome measure is the response rate defined as CR or mCR or PR after 3 cycles of treatment., Response will be assessed according to Savona et al., 20151.
Endpoint(s): Adverse events (AEs) and serious adverse events (SAEs), clinical laboratory values, vital signs, ECG, and ECHO/MUGA parameters, Overall survival (OS), time to leukemia transformation (TLT), median duration of response until EOT, Proportion of patients achieving hematologic improvement after 3 cycles of treatment (IWG 2018/2023 criteria), Proportion of patients achieving transfusion independence after 3 cycles of treatment (IWG 2018/2023 criteria), Change of quality of life after 3 cycles and 12 cycles of treatment compared to baseline

Source: https://euclinicaltrials.eu/ctis-public/view/2024-511102-22-00